EU clinical trial 2023-507657-15-00: I6T-MC-AMAP: A Phase 3, Multicenter, Open-Label Extension Study to Evaluate the Long-Term Efficacy and Safety of Mirikizumab in Patients with Moderately to Severely Active Ulcerative Colitis (LUCENT 3)
Protocol code: I6T-MC-AMAP
Sponsor: Eli Lilly & Co. (Pharmaceutical company). Phase: Therapeutic confirmatory (Phase III). Countries: Spain (ended), Netherlands (ended), Austria (ended), Romania (ongoing, recruitment ended), Hungary (ongoing, recruitment ended), Czechia (ended), Slovakia (ended), Latvia (ongoing, recruitment ended), France (ongoing, recruitment ended), Denmark (ended), Belgium (ended), Italy (ended), Lithuania (ended), Poland (ended).
Therapeutic area(s): Diseases [C] - Digestive System Diseases [C06]
Gender: Female, Male. Age: 18-64 years, 65+ years. Enrolment: 298.
Start date (EU): 2018-09-13. Decision date: 2023-11-29. Results received: No. Last updated: 2026-06-15.
Decision dates by country: ES: 2023-11-30, AT: 2023-11-30, NL: 2023-11-30, BE: 2023-11-30, DK: 2023-11-29, LV: 2023-11-30, FR: 2023-12-04, CZ: 2023-11-30, PL: 2024-01-26, LT: 2023-12-22, RO: 2023-12-05, SK: 2023-11-29, HU: 2023-11-30, IT: 2024-01-15

Condition(s): Ulcerative Colitis
Product: Mirikizumab, Mirikizumab

Primary endpoint: Percentage of participants in clinical remission. Clinical remission is based on the modified Mayo Score (MMS).
Endpoint(s): Percentage of participants in endoscopic remission, based on the Mayo Endoscopic Score (ES)., Percentage of participants who are hospitalized due to UC over time., Percentage of participants who undergo UC surgeries over time., IBDQ scores over time

Source: https://euclinicaltrials.eu/ctis-public/view/2023-507657-15-00